EU clinical trial 2022-502159-78-00: A double-blind, randomized, placebo-controlled trial to evaluate the efficacy, pharmacokinetics and safety of remibrutinib (LOU064) for 24 weeks in adolescents from 12 to less than 18 years of age with chronic spontaneous urticaria inadequately controlled by H1-antihistamines followed by an optional open-label extension for up to another 3 years and an optional safety long-term treatment-free follow-up period for up to an additional 3 years.
Protocol code: CLOU064F12301
Sponsor: Novartis Pharma AG (Pharmaceutical company). Phase: Therapeutic confirmatory (Phase III). Countries: Poland, Germany, Spain, Netherlands, Italy.
Therapeutic area(s): Diseases [C] - Skin and Connective Tissue Diseases [C17]
Gender: Female, Male. Age: 0-17 years. Enrolment: 27.
Start date (EU): 2023-12-06. Decision date: 2023-09-20. Results received: No. Last updated: 2024-07-03.
Decision dates by country: IT: 2023-09-20, PL: 2024-07-03, DE: 2023-09-20, ES: 2023-09-21, NL: 2023-09-21

Condition(s): Chronic Spontaneous Urticaria
Product: LOU064, Placebo to LOU064 25 mg film-coated tablet, LOU064, Placebo to LOU064 10 mg film-coated tablet

Primary endpoint: Absolute change from baseline in ISS7, HSS7, UAS7 at week 12
Endpoint(s): Concentration of remibrutinib at Week 12 including Cmax, Tmax and AUC, Absolute change from baseline in UAS7 at Week 12, Achievement of UAS7 ≤ 6 (yes/no) at Week 12 and over time, Achievement of UAS7 = 0 (yes/no) at Week 12 and over time, Absolute change from baseline in CDLQI score at Week 12, Number of weeks without angioedema, assessed by the cumulative number of weeks with an AAS7 = 0 response between baseline and Week 12, Occurrence of treatment emergent AEs, SAEs and laboratory and vital signs abnormalities during the core period, Occurrence of treatment-emergent adverse events, serious adverse events and laboratory and vital signs abnormalities during the OLE period

Source: https://euclinicaltrials.eu/ctis-public/view/2022-502159-78-00